EU clinical trial 2024-520075-28-01: The PREVENT AGITATION trial II – children ≤1 year
Sponsor: Rigshospitalet (Hospital/Clinic/Other health care facility). Phase: Therapeutic exploratory (Phase II). Countries: Denmark (temporarily halted).
Therapeutic area(s): Phenomena and Processes [G] - Musculoskeletal and Neural Physiological Phenomena [G11]
Gender: Female, Male. Age: 0-17 years. Enrolment: 286.
Status: Temporarily halted. Start date (EU): 2021-10-22. Decision date: 2025-01-29. Results received: No. Last updated: 2026-05-12.

Condition(s): Emergence agitation after anaesthesia
Product: Catapresan 150 mikrogram/ml injektionsvätska, lösning, SODIUM CHLORIDE

Primary endpoint: Emergence agitation measured on the Watcha score (1= calm, 4= agitated and thrashing around)7. The incidence of emergence agitation (Watcha score >2 during stay in the postanaesthetic care unit)., Pharmacokinetic parameter estimates for compartmental Clearance (CL), Volume of distribution (V) and T½
Endpoint(s): The amount of additional opioid needed during stay in the postanaesthetic care unit (calculated as morphine equivalents) for treatment of postoperative pain, No validated scale for assessment of PONV exists and PONV will be assessed by nausea/vomiting Yes or No. While vomiting is obvious, nausea may be considered to be present if the child refuses to eat and other causes are ruled out., The proportion of participants with 1) clinically relevant hypotension and, clinically relevant bradycardia, 2) clinically relevant bradycardia and clinically relevant apnoea.

Source: https://euclinicaltrials.eu/ctis-public/view/2024-520075-28-01